EU clinical trial 2023-504124-26-00: A Phase III, Randomised, Multicentre, Double-blind Study to Evaluate the Efficacy, Safety and Tolerability of Zibotentan/Dapagliflozin FDC Compared to Dapagliflozin Alone in Participants with Chronic Kidney Disease and High Proteinuria
Protocol code: D4325C00010
Sponsor: AstraZeneca AB (Pharmaceutical company). Phase: Therapeutic confirmatory (Phase III). Countries: Slovakia (ongoing, recruitment ended), Poland (ongoing, recruitment ended), Italy (ongoing, recruitment ended), Germany (ongoing, recruitment ended), Austria (ongoing, recruitment ended), Sweden (ongoing, recruitment ended), France (ongoing, recruitment ended), Bulgaria (ongoing, recruitment ended), Norway (ongoing, recruitment ended), Netherlands (ongoing, recruitment ended), Denmark (ongoing, recruitment ended), Spain (ongoing, recruitment ended).
Therapeutic area(s): Phenomena and Processes [G] - Metabolism [G03]
Gender: Female, Male. Age: 18-64 years, 65+ years. Enrolment: 328.
Status: Ongoing, recruitment ended. Start date (EU): 2024-04-04. Decision date: 2024-03-18. Results received: No. Last updated: 2026-06-04.
Decision dates by country: NL: 2024-03-18, ES: 2024-03-19, SE: 2024-03-25, DE: 2024-06-10, AT: 2024-03-25, NO: 2024-04-16, PL: 2024-03-25, FR: 2024-03-21, BG: 2024-03-25, DK: 2024-03-19, IT: 2024-03-20, SK: 2024-03-18

Condition(s): Chronic Kidney Disease and High Proteinuria
Product: Zibotentan + Dapagliflozin, Zibotentan + Dapagliflozin, DAPAGLIFLOZIN

Primary endpoint: Change in eGFR from baseline to Month 24
Endpoint(s): 1. Change from baseline in UACR, 2. Time to the first occurrence of any of the components of the renal composite endpoint of 40% sustained decline in eGFR or ESKD or renal death, 3. Change from baseline to UPCR

Source: https://euclinicaltrials.eu/ctis-public/view/2023-504124-26-00